EU clinical trial 2024-512077-27-00: EVALUATION OF THE EFFICACY OF INHALATORY SEDATION IN COMPARISON WITH CONVENTIONAL INTRAVENOUS SEDATION IN NEUROCRITIC PATIENTS
Protocol code: NEURO-CONDA
Sponsor: Hospital Universitari De Girona Doctor Josep Trueta (Hospital/Clinic/Other health care facility). Phase: Therapeutic use (Phase IV). Countries: Spain (ongoing, recruiting).
Therapeutic area(s): Analytical, Diagnostic and Therapeutic Techniques and Equipment [E] - Anesthesia and Analgesia [E03]
Gender: Female, Male. Age: 18-64 years, 65+ years. Enrolment: 24.
Status: Ongoing, recruiting. Start date (EU): 2024-04-04. Decision date: 2024-03-20. Results received: No. Last updated: 2024-08-05.

Condition(s): NEUROCRITIC PATIENTS
Product: PROPOFOL, ISOFLURANE, MIDAZOLAM

Primary endpoint: Sedation variables: RASS scale, Bispectral Index (BIS), Delta BIS index, required doses of intravenous or inhalation sedation during the study period, Placement of the Sedaconda device: in the mouth or on the inspiratory branch, recording of the ISOef value (expiratory fraction gas) during the study period. The upper permitted ISOef limit will be set at 1%. Respiratory, hemodynamic variables, neuromomitorization and infectious status
Endpoint(s): Adverse effects observed throughout the study. • Awakening time and presence/absence of delirium in this patient awakening process. • Alteration of liver function throughout the study. • Alteration of kidney function throughout the study. • Days spent in ICU. • Days spent in the hospital. • Mortality in ICU. • Hospital mortality, Data based on analgesia will be collected: Values obtained with NOL (Annex 9). The value indicates the degree of nociception and the required doses of intravenous opioids during the study period.

Source: https://euclinicaltrials.eu/ctis-public/view/2024-512077-27-00